EU clinical trial 2023-505812-39-00: A Phase III, Randomized, Double-Blind, Placebo-Controlled Study Evaluating the Efficacy and Safety of Inavolisib Plus Palbociclib and Fulvestrant Versus Placebo Plus Palbociclib and Fulvestrant in Patients with PIK3CA -Mutant, Hormone Receptor-Positive, HER2 -Negative Locally Advanced or Metastatic Breast Cancer
Protocol code: WO41554
Sponsor: F. Hoffmann-La Roche AG (Pharmaceutical company). Phase: Therapeutic confirmatory (Phase III). Countries: Belgium (ended), Italy (ended), Hungary (ended), Greece (ongoing, recruitment ended), Germany (ended), Poland (ended), Portugal (ended), Spain (ongoing, recruitment ended), France (ended).
Therapeutic area(s): Diseases [C] - Neoplasms [C04]
Gender: Female, Male. Age: 18-64 years, 65+ years. Enrolment: 91.
Start date (EU): 2020-08-28. Decision date: 2024-07-04. Results received: No. Last updated: 2026-03-18.
Decision dates by country: PT: 2024-07-04, BE: 2024-07-05, IT: 2024-07-29, HU: 2024-07-04, PL: 2024-07-18, FR: 2024-07-08, DE: 2024-07-08, GR: 2024-09-18, ES: 2024-07-08

Condition(s): HR+/HER2-Negative Locally Advanced or Metastatic Breast cancer with PIK3CA mutation
Product: INAVOLISIB, PALBOCICLIB, Faslodex 250 mg solution for injection., INAVOLISIB, INAVOLISIB, PALBOCICLIB, INAVOLISIB, PALBOCICLIB

Primary endpoint: 1. Progression-free survival
Endpoint(s): 1. Overall survival, 2. Objective response rate, 3. Best overall response rate, 4. Clinical benefit rate, 5. Duration of response, 6. Time to confirmed deterioration (TTCD) in pain, 7. TTCD in physical function, 8. TTCD in Role Function, 9. TTCD in GHS/HRQoL, 10. Incidence and severity of adverse events, with severity determined according to National Cancer Institute Common Terminology Criteria for Adverse Events, Version 5.0 (NCI CTCAE v5.0), 11. Change from baseline in targeted vital signs, 12. Change from baseline in targeted clinical laboratory test results, 13. Change from baseline in ECG parameters, 14. Plasma concentration of inavolisib at specified timepoints, 15. Plasma concentration of inavolisib at additional specified timepoints in patients enrolled in China, 16. Plasma concentration of palbociclib at specified timepoints, 17. Plasma concentration of fulvestrant at specified timepoints

Source: https://euclinicaltrials.eu/ctis-public/view/2023-505812-39-00